EU clinical trial 2025-521887-37-00: A Study of LY4337713 in Participants With FAP-Positive Solid Tumors (FiREBOLT)
Protocol code: J6K-OX-JSFA
Sponsor: Eli Lilly & Co. (Pharmaceutical company). Phase: Human Pharmacology (Phase I)- First administration to humans. Countries: Germany (authorised, recruitment pending), Netherlands (authorised, recruitment pending).
Therapeutic area(s): Diseases [C] - Neoplasms [C04]
Gender: Female, Male. Age: 18-64 years, 65+ years. Enrolment: 64.
Status: Authorised, recruitment pending. Decision date: 2026-07-07. Results received: No. Last updated: 2026-08-05.
Decision dates by country: NL: 2026-07-13, DE: 2026-07-07

Condition(s): Ovarian Neoplasms; Breast Neoplasms; Pancreatic Intraductal Neoplasms; Colorectal Neoplasms; Esophageal Neoplasms; Stomach Neoplasms; Cholangiocarcinoma

Source: https://euclinicaltrials.eu/ctis-public/view/2025-521887-37-00